EU clinical trial 2024-519829-38-00: (21466) A multicenter, randomized, double-blind, placebo-controlled, Phase 3 study to investigate the efficacy, safety, and PK/ PD of finerenone, in addition to standard-of-care, in pediatric patients, 6 months to < 18 years of age, with heart failure (HF) and left ventricular systolic dysfunction (LVSD)
Protocol code: 21466
Sponsor: Bayer AG (Pharmaceutical company). Phase: Therapeutic confirmatory (Phase III). Countries: Czechia (authorised, recruiting), Poland (authorised, recruiting), Portugal (ongoing, recruiting), Austria (authorised, recruiting), Finland (ongoing, recruiting), Greece (ongoing, recruiting), Bulgaria (ongoing, recruiting), Sweden (authorised, recruiting), Spain (ongoing, recruiting), Italy (ongoing, recruiting), Belgium (ongoing, recruiting), Hungary (ongoing, recruiting), Germany (authorised, recruiting).
Therapeutic area(s): Diseases [C] - Cardiovascular Diseases [C14]
Gender: Female, Male. Age: 0-17 years. Enrolment: 60.
Start date (EU): 2026-01-09. Decision date: 2025-12-05. Results received: No. Last updated: 2026-06-26.
Decision dates by country: BG: 2025-12-10, DE: 2025-12-10, GR: 2025-12-08, PT: 2025-12-10, ES: 2025-12-10, SE: 2025-12-05, HU: 2025-12-10, PL: 2025-12-09, FI: 2026-01-07, AT: 2025-12-08, BE: 2025-12-05, CZ: 2025-12-09, IT: 2025-12-10

Condition(s): Heart failure due to systemic left ventricular systolic dysfunction
Product: BAY 94-8862, Finerenone Bayer, Finerenone, Placebo BAY 948862 tablets, Finerenone, Placebo BAY 948862

Primary endpoint: Change in NT-proBNP from baseline to 3 months in participants receiving active study intervention compared to placebo
Endpoint(s): Number of participants with treatment-emergent adverse events (TEAEs), Change in serum potassium levels from baseline to end of treatment (EoT), Change in systolic blood pressure (SBP) from baseline to EoT, Change in renal function from baseline to EoT, Change in echocardiographic parameters of left ventricular systolic function and size from baseline to EoT, Total number of cardiovascular outcome events, including cardiovascular death, heart transplantation, and clinical worsening of heart failure from baseline to EoT, Maximum observed finerenone concentration in plasma after multiple doses (Cmax, md), Area under the curve for finerenone concentration in plasma after multiple doses (AUCτ,md)

Source: https://euclinicaltrials.eu/ctis-public/view/2024-519829-38-00